EU clinical trial 2022-501783-18-00: A Phase 2, Randomized, Double-Blind, Placebo-Controlled Study to Evaluate the Efficacy, Safety, Tolerability, Pharmacodynamics, and Pharmacokinetics of BIA 28-6156 in Subjects With Parkinson’s Disease With a Pathogenic Variant in the Glucocerebrosidase (GBA1) Gene
Protocol code: BIA 28-6156-201
Sponsor: Bial R&D Investments S.A. (Pharmaceutical company). Phase: Therapeutic exploratory (Phase II). Countries: Germany (ended), Netherlands (ended), Sweden (ended), Portugal (ended), France (ended), Spain (ended), Poland (ended), Italy (ended).
Therapeutic area(s): Diseases [C] - Nervous System Diseases [C10]
Gender: Female, Male. Age: 18-64 years, 65+ years. Enrolment: 96.
Status: Ended. Start date (EU): 2023-07-21. End date (EU): 2026-04-02. End date: 2026-04-03. Decision date: 2023-06-01. Results received: No. Last updated: 2025-09-11.
Decision dates by country: FR: 2023-06-14, PL: 2023-07-31, NL: 2023-07-21, DE: 2023-07-11, IT: 2023-07-31, PT: 2023-07-17, SE: 2023-07-18, ES: 2023-06-01

Condition(s): Parkinson’s Disease
Product: BIA 28-6156, Placebo, BIA 28-6156

Primary endpoint: Time from baseline to clinically meaningful progression on motor aspects of experiences of daily living, as assessed by ≥2-point increase in the MDS-UPDRS Part II score and no improvement (i.e., difference of zero or higher) in the Part III score
Endpoint(s): • Time from baseline to clinically meaningful progression on motor signs of the disease, as assessed by a ≥5-point increase in the MDS-UPDRS Part III score (key secondary endpoint) • Further Secondary, Exploratory, Safety, Pharmacodynamic, Pharmacokinetics and Pharmacogenomic Endpoints are visible in the study protocol

Source: https://euclinicaltrials.eu/ctis-public/view/2022-501783-18-00